EU clinical trial 2023-507444-37-00: A multicenter open-label study to evaluate safety and dosimetry of Lutathera in adolescent patients with somatostatin receptor positive gastroenteropancreatic neuroendocrine (GEP-NET) tumors, pheochromocytoma and paragangliomas
Protocol code: CAAA601A32201
Sponsor: Advanced Accelerator Applications (Pharmaceutical company). Phase: Therapeutic exploratory (Phase II). Countries: France (ongoing, recruitment ended), Spain (ongoing, recruitment ended), Poland (ongoing, recruitment ended).
Therapeutic area(s): Diseases [C] - Neoplasms [C04]
Gender: Female, Male. Age: 0-17 years. Enrolment: 5.
Status: Ongoing, recruitment ended. Start date (EU): 2021-04-21. Decision date: 2024-07-09. Results received: No. Last updated: 2026-05-21.
Decision dates by country: PL: 2024-08-06, ES: 2024-07-09, FR: 2024-07-10

Condition(s): somatostatin receptor positive gastroenteropancreatic neuroendocrine (GEP-NET) tumors, pheochromocytoma and paragangliomas
Product: LysaKare 25 g/25 g solution for infusion, Lutathera 370 MBq/mL solution for infusion

Primary endpoint: Target organ (e.g. kidney and bone marrow) absorbed radiation doses in adolescents with SSTR-positive GEP-NETs and PPGLs as a pooled cohort., The incidence of adverse events (AEs) and laboratory toxicities after the 1st Lutathera administration in adolescents with SSTR-positive GEPNETs and PPGLs as a pooled cohort
Endpoint(s): The incidence of adverse events (AEs) and laboratory toxicities until 6 months after the last Lutathera dose (short-term follow-up) in adolescents with SSTR-positive GEP-NETs and PPGLs as a pooled cohort., The incidence of adverse events (AEs) and laboratory abnormalities during the long term follow-up of 5 years and 10 years after the last Lutathera dose in adolescents with SSTR-positive GEP-NETs and PPGLs as a pooled cohort., Calculated organ absorbed doses and PK parameters based on imaging/blood radioactivity concentration data from adolescent patients with SSTR-positive GEP-NETs and PPGLs as a pooled cohort compared to the predicted distribution /organ absorbed doses

Source: https://euclinicaltrials.eu/ctis-public/view/2023-507444-37-00